EU clinical trial 2025-523096-34-00: The INFLUENCE Trial: Improving EveNt Free Survival by Optimizing FLUdarabine Exposure during LymphodepletioN for CAR T CEll Therapy: a randomized, multi-center study of children and young adults with B-cell acute lymphoblastic leukemia
Protocol code: INFLUENCE
Sponsor: Prinses Maxima Centrum voor Kinderoncologie B.V. (Hospital/Clinic/Other health care facility). Phase: Therapeutic confirmatory (Phase III). Countries: Spain (authorised, recruitment pending), Germany (authorised, recruitment pending), Netherlands (ongoing, recruiting).
Therapeutic area(s): Diseases [C] - Hemic and Lymphatic Diseases [C15]
Gender: Female, Male. Age: 0-17 years, 18-64 years. Enrolment: 35.
Start date (EU): 2026-06-11. Decision date: 2026-04-16. Results received: No. Last updated: 2026-04-27.
Decision dates by country: NL: 2026-04-16, DE: 2026-04-16, ES: 2026-04-27

Condition(s): B-cell Acute Lymphoblastic Leukemia
Product: Fludarabine phosphate 25 mg/ml Concentrate for Solution for Injection or Infusion

Primary endpoint: EFS is defined as time from randomization until non-response at day 28 after CAR T cell infusion, loss of B-cell aplasia <6 months from the time of CAR T cell infusion, disease relapse, initiation of anti-leukemic therapy or death of any cause
Endpoint(s): Death from any cause from the day of randomization., Non-response at 28 days, Cumulative incidence of relapse is defined as time from CAR T cell infusion until disease relapse in patients with a morphological complete response on day 28, Cumulative incidence of initiation of anti-leukemic therapy during the first two years after CAR T cell infusion, Type, incidence, severity, seriousness and relationship of CRS, ICANS, IEC-HS, cytopenia day 28 – day 180 (grade 3-4), and infectious adverse events (grade ≥3) during the first 180 days after CAR T cell infusion, Duration of B-cell aplasia and CAR T cell numbers from the day of CAR T cell infusion until 1 year, Duration of B-cell aplasia in the bone marrow from the day of CAR T cell infusion until 6 months after CAR T cell infusion, Definition of accuracy of fludarabine therapeutic drug monitoring (percentage of patients within the target of 18 mg*h/L, range 17.5-18.5 mg*h/L), Patient-reported outcome measures

Source: https://euclinicaltrials.eu/ctis-public/view/2025-523096-34-00